EU clinical trial 2023-509169-19-00: B7461006 - A PHASE 3, RANDOMIZED, OPEN-LABEL STUDY OF LORLATINIB (PF-06463922) MONOTHERAPY VERSUS CRIZOTINIB MONOTHERAPY IN THE FIRST-LINE TREATMENT OF PATIENTS WITH ADVANCED ALK-POSITIVE NON-SMALL CELL LUNG CANCER
Protocol code: B7461006
Sponsor: Pfizer Inc. (Pharmaceutical company). Phase: Therapeutic confirmatory (Phase III). Countries: Poland (ongoing, recruitment ended), Netherlands (ongoing, recruitment ended), Belgium (ongoing, recruitment ended), Czechia (ongoing, recruitment ended), Italy (ongoing, recruitment ended), Germany (ongoing, recruitment ended), France (ongoing, recruitment ended), Spain (ongoing, recruitment ended).
Therapeutic area(s): Diseases [C] - Neoplasms [C04]
Gender: Female, Male. Age: 18-64 years. Enrolment: 33.
Status: Ongoing, recruitment ended. Start date (EU): 2017-07-11. Decision date: 2024-06-18. Results received: No. Last updated: 2026-06-04.
Decision dates by country: BE: 2024-06-20, IT: 2024-06-24, NL: 2024-06-24, PL: 2024-07-05, FR: 2024-06-20, ES: 2024-06-19, DE: 2024-06-19, CZ: 2024-06-18

Condition(s): Advanced ALK positive non-small cell lung cancer
Product: LORLATINIB

Primary endpoint: • PFS based on blinded independent central review (BICR) assessment (RECIST v.1.1).
Endpoint(s): • Efficacy: OS, PFS based on Investigator’s assessment, OR based on BICR and on Investigator’s assessment; intracranial OR (IC OR), IC TTP, DR and IC-DR, TTR and IC-TTR all by BICR (RECIST v. 1.1) and PFS2; IC-OR, IC-TTP, IC-DR, IC-TTR and DR based on the investigator’s assessment., • Safety: AEs (as graded by NCI CTCAE v.4.03); laboratory abnormalities (as graded by NCI CTCAE v.4.03); vital signs (blood pressure, pulse rate) and body weight; electrocardiograms (ECGs); echocardiogram or MUGA scan; ophthalmologic data., • PROs as assessed by EORTC QLC C30, EORTC QLQ LC13, EQ 5D 5L., • Tumor tissue biomarkers including, but not limited to, ALK gene rearrangement and/or mutation as measured by next generation sequencing (NGS) and/or immunohistochemistry (IHC)., • Peripheral blood cfDNA (circulating free Deoxyribonucleic acid) biomarkers including, but not limited to, ALK gene rearrangement and/or ALK kinase domain mutations.

Source: https://euclinicaltrials.eu/ctis-public/view/2023-509169-19-00